EU clinical trial 2023-510355-36-00: Exploratory Pragmatic trial of fosfomycin-trometamol treatment of male urinary tract infections in primary care.
Protocol code: 2021/0376/HP
Sponsor: CHU De Rouen (Hospital/Clinic/Other health care facility). Phase: Therapeutic confirmatory (Phase III). Countries: France (authorised, recruitment pending).
Therapeutic area(s): Diseases [C] - Bacterial Infections and Mycoses [C01]; Diseases [C] - Male Urogenital Diseases [C12]
Gender: Male. Age: 18-64 years, 65+ years. Enrolment: 110.
Status: Authorised, recruitment pending. Decision date: 2024-10-18. Results received: No. Last updated: 2024-10-18.

Condition(s): Male Urinary Tract Infection
Product: FOSFOMYCINE ARROW 3 g, granulés pour solution buvable en sachet

Primary endpoint: The primary endpoint was defined as the absence of clinical treatment failure up to 14 days after the end of antibiotic treatment. Failure is defined according to SPILF recommendations by : - a change of antibiotic treatment to a reference treatment (see above) for urinary tract infection ; - or/and hospitalization for urinary tract infection ; - or/and acute retention of urine ; - or/and a new consultation for worsening or persistence of symptoms ; - or/and onset of fever > 38°C
Endpoint(s): Improvement in functional urinary symptomatology, 2-5 days 28-35 days and 3 months after the start of treatment with FT, Negative ECBU 10 to 12 weeks after end of treatment, negative ECBU (leukocyturia < 10/mm3 OR leukocyturia > 10/mm3 AND bacteriuria < 103/mm3 or bacteriuria with a different pathogen) taken 14 to 21 days after the end of antibiotic treatment, Regression of urinary signs 10 to 12 weeks after the end of treatment, Adverse events reported by the patient and recorded by the investigating physician during antibiotic treatment and in the 14 days following the end of treatment

Source: https://euclinicaltrials.eu/ctis-public/view/2023-510355-36-00